EU clinical trial 2024-513462-19-00: A Phase 3, 24-Week, Randomized, Double-Blind, Placebo-Controlled, Parallel-Arm Efficacy and Safety Study with Open-label Extension of BLU-5937 in Adult Participants with Refractory Chronic Cough Including Unexplained Chronic Cough (CALM-2)
Protocol code: BUS-P3-02
Sponsor: Bellus Health Inc. (Pharmaceutical company). Phase: Therapeutic confirmatory (Phase III). Countries: Germany (ended), Slovakia (ended), Czechia (ended), Poland (ended).
Therapeutic area(s): Diseases [C] - Respiratory Tract Diseases [C08]
Gender: Female, Male. Age: 18-64 years, 65+ years. Enrolment: 257.
Status: Ended. Start date (EU): 2023-03-30. End date (EU): 2026-07-17. End date: 2026-07-17. Decision date: 2024-08-08. Results received: No. Last updated: 2026-05-22.
Decision dates by country: CZ: 2024-09-03, PL: 2025-10-31, SK: 2024-08-08, DE: 2024-08-15

Condition(s): Refractory Chronic Cough, Including Unexplained Chronic Cough
Product: Tablets are oval, biconvex, plain and white to off white, Tablets are oval, biconvex, plain and white to off white, BLU-5937

Primary endpoint: 24-hour cough frequency at Week 24 by a cough monitor in adult participants • Incidence of AEs and SAEs up to Week 24 • Incidence of AEMIs up to Week 24 • Incidence of study treatment discontinuations due to AEs and SAEs leading to study withdrawal up to Week 24 • Changes from Baseline in vital signs at Week 24, clinical laboratory values at Week 24 • Changes from Baseline in ECG values at Week 24
Endpoint(s): CS-VAS • Change from Baseline in CS-VAS at Week 24 • CS-VAS response at Week 24 Objective cough frequency recording • Awake cough frequency at Week 24 • 24-hour cough response from Baseline at Week 24 LCQ • Change from Baseline in the LCQ total score at Week 24 • LCQ response at Week 24

Source: https://euclinicaltrials.eu/ctis-public/view/2024-513462-19-00